EU clinical trial 2025-520690-39-00: A Phase IIb, Multicenter, Double-Blind, Placebo-Controlled Induction Study with an Active Treatment Extension to Assess the Efficacy, Safety, and Pharmacokinetics of RO7837195 in Patients with Moderately to Severely Active Ulcerative Colitis
Protocol code: GA45977
Sponsor: Genentech Inc. (Pharmaceutical company). Phase: Therapeutic exploratory (Phase II). Countries: France (ongoing, recruiting), Italy (ongoing, recruiting), Czechia (ongoing, recruiting), Poland (ongoing, recruiting), Germany (authorised, recruiting).
Therapeutic area(s): Diseases [C] - Digestive System Diseases [C06]
Gender: Female, Male. Age: 18-64 years, 65+ years. Enrolment: 84.
Start date (EU): 2025-11-04. Decision date: 2025-10-03. Results received: No. Last updated: 2026-07-28.
Decision dates by country: FR: 2025-10-03, PL: 2025-10-07, DE: 2025-10-08, IT: 2025-10-03, CZ: 2025-10-07

Condition(s): Moderately to Severely Active Ulcerative Colitis (UC)
Product: RO7837195, RO7837195

Primary endpoint: Clinical remission at Week 12, with clinical remission defined as mMS of ≤ 2, with Mayo subscores meeting the following criteria: – Stool frequency subscore ≤ 1 – Rectal bleeding subscore = 0 Endoscopy subscore ≤ 1 (score of 1 modified to exclude friability)
Endpoint(s): Clinical response at Week 12, with clinical response defined as meeting both of the following sets of criteria: – Decrease from baseline in the mMS of ≥ 2 and ≥ 30% reduction from baseline - Decrease in Mayo rectal bleeding subscore of ≥ 1 or absolute rectal bleeding subscore of ≤1, Endoscopic improvement at Week 12, with endoscopic improvement defined as a Mayo endoscopy subscore of ≤1 (score of 1 modified to exclude friability), Endoscopic remission at Week 12, with endoscopic remission defined as a Mayo endoscopy subscore of 0, Incidence and severity of adverse events, with severity determined according to the National Cancer Institute's Common Terminology Criteria for Adverse Events, Version 5.0 (CTCAE v5.0) grading scale, Change from baseline in selected vital signs, Change from baseline in selected clinical laboratory test results, Serum concentration of RO7837195 at specified timepoints, Prevalence of anti-drug antibodies (ADAs) at baseline and incidence of ADAs during the study

Source: https://euclinicaltrials.eu/ctis-public/view/2025-520690-39-00